EU clinical trial 2024-516604-41-00: A Single-Arm, Open-Label, Multicenter Phase 2 Study to Evaluate the Efficacy and Safety of Taletrectinib in Patients with Advanced or Metastatic ROS1 Positive NSCLC and Other Solid Tumors
Protocol code: AB-106-G208
Sponsor: Anheart Therapeutics Inc. (Pharmaceutical company). Phase: Therapeutic exploratory (Phase II). Countries: Italy (ongoing, recruiting), Spain (ongoing, recruiting), Poland (ongoing, recruitment ended), France (ongoing, recruiting).
Therapeutic area(s): Diseases [C] - Neoplasms [C04]
Gender: Female, Male. Age: 18-64 years, 65+ years. Enrolment: 125.
Start date (EU): 2022-08-08. Decision date: 2024-10-10. Results received: No. Last updated: 2026-07-24.
Decision dates by country: ES: 2024-10-10, PL: 2024-10-13, IT: 2024-10-21, FR: 2024-10-10

Condition(s): Non-small Cell Lung Cancer
Product: Taletrectinib, Taletrectinib

Primary endpoint: For cohorts 1 to 5: Confirmed ORR according to Response Evaluation Criteria in Solid Tumors (RECIST) 1.1 assessed by an independent radiology review committee (IRC) (Cohorts 1-2). For cohort 6: For Cohort 6 Primary end point please see section 1.1 in Protocol.
Endpoint(s): For cohorts 1 to 5: Efficacy - DOR according to RECIST 1.1 assessed by IRC (Cohorts 1-2), For cohorts 1 to 5: Efficacy - PFS according to RECIST 1.1 assessed by IRC (Cohorts 1-2), For cohorts 1 to 5: Efficacy - TTF according to RECIST 1.1 assessed by IRC (Cohorts 1-2), For cohorts 1 to 5: Efficacy - TTR according to RECIST 1.1 assessed by IRC (Cohorts 1-2), For cohorts 1 to 5: Efficacy - ORR, DOR, and PFS according to RECIST 1.1 assessed by investigators (Cohorts 1-2), For cohorts 1 to 5: Efficacy - Confirmed intracranial (IC)-ORR, IC-DOR, IC-PFS, and time to intracranial progression (TTiP) according to mRECIST 1.1 assessed by IRC (Cohorts 1-2), For cohorts 1 to 5: Efficacy - OS (Cohorts 1-2), For cohort 6: Efficacy - Confirmed ORR according to RECIST 1.1 assessed by IRC and investigators. - Confirmed IC-ORR according to mRECIST 1.1 assessed by IRC.

Source: https://euclinicaltrials.eu/ctis-public/view/2024-516604-41-00